EU clinical trial 2024-516001-23-00: MAV-RAPA: Prospective evaluation of the efficacy of sirolimus (Rapamune) in the treatment of superficial arteriovenous malformations.
Sponsor: Centre Hospitalier Universitaire Amiens Picardie (Hospital/Clinic/Other health care facility). Phase: Therapeutic exploratory (Phase II). Countries: France (authorised, recruitment pending).
Therapeutic area(s): Not possible to specify
Gender: Female, Male. Age: 0-17 years, 18-64 years, 65+ years. Enrolment: 50.
Status: Authorised, recruitment pending. Decision date: 2025-01-17. Results received: No. Last updated: 2025-01-17.

Condition(s): superficial arteriovenous malformations
Product: Rapamune 1 mg coated tablets, SOLUPRED 20 mg, comprimé orodispersible, SOLUPRED 5 mg, comprimé orodispersible

Primary endpoint: the proportion of patients with a reduction in tumour volume of the 30% reduction in AVM tumour volume by angioscannographic criteria during the first year of the study
Endpoint(s): Assessment of treatment efficacy at three months, six months, nine months

Source: https://euclinicaltrials.eu/ctis-public/view/2024-516001-23-00